EU clinical trial 2024-512991-36-00: The ENERGY 2 Study: An Open-Label Phase 3 Study to Evaluate the Efficacy and Safety of INZ-701 in Infants with Ectonucleotide Pyrophosphatase/Phosphodiesterase 1 (ENPP1) Deficiency
Protocol code: INZ701-105
Sponsor: Inozyme Pharma Inc. (Pharmaceutical company). Phase: Therapeutic confirmatory (Phase III). Countries: Hungary (authorised, recruiting), France (ongoing, recruiting), Sweden (ended), Italy (authorised, recruiting), Spain (authorised, recruiting).
Therapeutic area(s): Diseases [C] - Congenital, Hereditary, and Neonatal Diseases and Abnormalities [C16]
Gender: Female, Male. Age: 0-17 years. Enrolment: 6.
Start date (EU): 2024-10-24. Decision date: 2024-09-23. Results received: No. Last updated: 2026-07-31.
Decision dates by country: SE: 2024-09-25, IT: 2024-09-23, ES: 2024-09-27, HU: 2024-09-30, FR: 2024-09-24

Condition(s): Ectonucleotide Pyrophosphatase/Phosphodiesterase 1 (ENPP1) Deficiency
Product: INZ-701, INZ-701

Primary endpoint: Change from Baseline in plasma PPi concentration through Week 52, Overall survival based on time from date of birth to event of all-cause mortality through Week 52
Endpoint(s): Change from Baseline in left ventricular ejection fraction via echocardiography through Week 52, Incidence of heart failure, Change from Baseline in vascular calcification in the coronary arteries and aorta via CT scan through Week 52, Change from Baseline in growth Z-score (body length and weight) through Week 52, Growth velocity, Number of days of mechanical ventilation, Measurement of INZ-701 plasma concentration and ENPP1 activity

Source: https://euclinicaltrials.eu/ctis-public/view/2024-512991-36-00